EU clinical trial 2023-506882-70-00: A study to compare efficacy, safety, and immune response of GME751 and EU-authorized Keytruda in adult participants with untreated metastatic lung cancer
Protocol code: CGME751A12301
Sponsor: H e x a l AG (Pharmaceutical company). Phase: Therapeutic confirmatory (Phase III). Countries: Spain (ended), Romania (ended), Germany (ended).
Therapeutic area(s): Diseases [C] - Neoplasms [C04]
Gender: Female, Male. Age: 18-64 years, 65+ years. Enrolment: 89.
Status: Ended. Start date (EU): 2024-08-16. End date (EU): 2025-12-23. End date: 2026-03-16. Decision date: 2024-04-19. Results received: No. Last updated: 2025-11-03.
Decision dates by country: RO: 2024-04-19, DE: 2024-04-22, ES: 2024-04-19

Condition(s): Non-small-cell lung cancer

Source: https://euclinicaltrials.eu/ctis-public/view/2023-506882-70-00